EU clinical trial 2025-522151-26-00: A Global, Phase 3, Randomized, Multicenter, Open-Label Study to Evaluate the Efficacy and Safety of Firmonertinib Compared with Investigator’s Choice of Osimertinib or Afatinib as First-Line Treatment in Participants Who Have Locally Advanced or Metastatic Non-Small-Cell Lung Cancer with Epidermal Growth Factor Receptor P-Loop and Alpha C-Helix Compressing (PACC) Uncommon Mutations (ALPACCA)
Protocol code: FURMO-006
Sponsor: Arrivent Biopharma Inc. (Pharmaceutical company). Phase: Therapeutic confirmatory (Phase III). Countries: Greece (ongoing, recruiting), France (ongoing, recruiting), Spain (ongoing, recruiting), Italy (ongoing, recruiting).
Therapeutic area(s): Diseases [C] - Neoplasms [C04]
Gender: Female, Male. Age: 18-64 years, 65+ years. Enrolment: 36.
Status: Ongoing, recruiting. Start date (EU): 2026-02-06. Decision date: 2025-12-10. Results received: No. Last updated: 2026-08-06.
Decision dates by country: GR: 2025-12-11, FR: 2025-12-15, ES: 2025-12-12, IT: 2025-12-10

Condition(s): Advanced or Metastatic Non-Small-Cell Lung Cancer With Epidermal Growth Factor Receptor P-Loop and Alpha C-Helix Compressing (PACC) Uncommon Mutations
Product: AFATINIB, OSIMERTINIB, AFATINIB, Furmonertinib, OSIMERTINIB, AFATINIB

Primary endpoint: 1. Progression Free Survival (PFS) determined by blinded independent central review (BICR), 2. Confirmed overall response rate (ORR) as determined by BICR

Source: https://euclinicaltrials.eu/ctis-public/view/2025-522151-26-00